EU clinical trial 2023-504628-24-00: A Phase 2b, Double-Blind, Randomized Extension Study to Evaluate the Long-Term Safety and Efficacy of Votoplam in Participants With Huntington’s Disease
Protocol code: CHTT227A12201
Sponsor: Novartis Pharma AG (Pharmaceutical company). Phase: Therapeutic exploratory (Phase II). Countries: Germany (ongoing, recruitment ended), France (ongoing, recruitment ended), Austria (ongoing, recruitment ended), Italy (ongoing, recruitment ended), Spain (ongoing, recruitment ended), Netherlands (ongoing, recruitment ended).
Therapeutic area(s): Diseases [C] - Congenital, Hereditary, and Neonatal Diseases and Abnormalities [C16]
Gender: Female, Male. Age: 18-64 years, 65+ years. Enrolment: 172.
Status: Ongoing, recruitment ended. Start date (EU): 2023-10-31. Decision date: 2023-09-04. Results received: No. Last updated: 2026-06-26.
Decision dates by country: AT: 2023-11-30, IT: 2023-11-29, DE: 2023-09-04, FR: 2023-09-04, NL: 2023-11-13, ES: 2023-12-04

Condition(s): Huntington's Disease
Product: HTT227, HTT227, Placebo to 10 mg tablet, Placebo to 5 mg tablet

Primary endpoint: Safety profile as characterized by TEAEs, laboratory abnormalities, vital signs, physical examination, C-SSRS, Evaluate blood tHTT protein levels over time
Endpoint(s): Change in caudate volume as assessed by vMRI over time, Change in cUHDRS scores over time, Evaluate CSF mHTT protein levels over time, Evaluate blood mHTT protein levels over time

Source: https://euclinicaltrials.eu/ctis-public/view/2023-504628-24-00